EU clinical trial 2024-518419-20-00: New Beacon
Sponsor: Rigshospitalet (Hospital/Clinic/Other health care facility). Phase: Therapeutic exploratory (Phase II). Countries: Denmark (ongoing, recruiting).
Therapeutic area(s): Diseases [C] - Neoplasms [C04]
Gender: Female, Male. Age: 18-64 years, 65+ years. Enrolment: 53.
Status: Ongoing, recruiting. Start date (EU): 2024-10-23. Decision date: 2024-10-23. Results received: No. Last updated: 2024-10-23.

Condition(s): BRAF V600E mutated colorectal cancer

Source: https://euclinicaltrials.eu/ctis-public/view/2024-518419-20-00